EU clinical trial 2023-509888-24-00: Effect of intravenous Lidocaine bolus on the median effective concentration (EC50) of Propofol during target controlled infusion (TCI : Schnider model) for gastroscopy in adult patients : a prospective, randomized, double-blinded study
Sponsor: Hopital Erasme (Hospital/Clinic/Other health care facility). Phase: Therapeutic use (Phase IV). Countries: Belgium (ended).
Therapeutic area(s): Analytical, Diagnostic and Therapeutic Techniques and Equipment [E] - Anesthesia and Analgesia [E03]
Gender: Female, Male. Age: 18-64 years. Enrolment: 50.
Status: Ended. Start date (EU): 2024-04-08. End date (EU): 2024-06-28. Decision date: 2024-03-25. Results received: No. Last updated: 2024-03-25.

Condition(s): Gastroscopy
Product: NaCl 0,9 % B. Braun, solution injectable, Propofol B. Braun 1 % (10 mg/ml), émulsion injectable ou pour perfusion, Linisol 2 %, solution injectable

Primary endpoint: estimated EC50 of propofol for gastroscope introduction without movements
Endpoint(s): number of participants with moderate hypoxemia (pulse saturation below 95%) during propofol sedation and gastroscopy, number of participants with hypotension (mean arterial pressure below 65 mmHg) during propofol sedation and gastroscopy, number of participants presenting cough cough suggesting to light sedation during propofol sedation and gastroscopy, number of participants presenting laryngospasm laryngospasm suggesting to light sedation during propofol sedation and gastroscopy, number of participants presenting involuntary movements involuntary movements suggesting to light sedation during propofol sedation and gastroscopy, number of participants presenting side effects of lidocaine administration metallic taste, tinnitus, anaphylaxis, score of Endoscopist satisfaction (1-5) after completion of the procedure (Endoscopist satisfaction :1 = very bad; 2=bas; 3=good; 4=very good; 5= excellent), score of Patient satisfaction (1-5) at recovery room discharge, an average of 1 hour after completed procedure (Patient satisfaction :1 = very bad; 2=bas; 3=good; 4=very good; 5= excellent) ], throat pain (analog digital scale from 1 to 10) at recovery room discharge, an average of 1 hour after completed procedure, Time to anesthesia recover : Time between stopping Propofol and recovering a MOAA/S score ≥ 4, Time for post anesthesic care unit discharge

Source: https://euclinicaltrials.eu/ctis-public/view/2023-509888-24-00